EU clinical trial 2023-503438-40-00: A Phase 1/2, First-in-Human, Open-Label, Dose Escalation Study of Teclistamab, a Humanized BCMA x CD3 Bispecific Antibody, in Subjects with Relapsed or Refractory Multiple Myeloma
Protocol code: 64007957MMY1001
Sponsor: Janssen - Cilag International (Pharmaceutical company). Phase: Phase I and Phase II (Integrated)- First administration to humans. Countries: Spain (ongoing, recruitment ended), Italy (ended), Belgium (ended), Netherlands (ongoing, recruitment ended), Germany (ended), France (ongoing, recruitment ended), Sweden (ongoing, recruitment ended).
Therapeutic area(s): Diseases [C] - Hemic and Lymphatic Diseases [C15]
Gender: Female, Male. Age: 18-64 years, 65+ years. Enrolment: 267.
Start date (EU): 2017-10-05. Decision date: 2024-07-31. Results received: No. Last updated: 2026-02-02.
Decision dates by country: BE: 2024-08-01, ES: 2024-08-02, SE: 2024-08-02, FR: 2024-07-31, NL: 2024-08-01, DE: 2024-08-01, IT: 2024-08-05

Condition(s): Relapsed/Refractory Multiple Myeloma
Product: teclistamab, Privigen 100 mg/ml solution for infusion, Privigen 100 mg/ml solution for infusion, teclistamab, Privigen 100 mg/ml solution for infusion

Primary endpoint: Part 1 (Dose Escalation): Frequency and type of DLT; Part 2 (Dose Expansion): Occurrence and severity of adverse events, serious adverse events, and laboratory values; Part 3 (Phase 2): ORR (PR or better) as defined by the IMWG criteria

Source: https://euclinicaltrials.eu/ctis-public/view/2023-503438-40-00